EU clinical trial 2024-514949-11-00: Apneic oxygenation with high-flow nasal oxygenation after preoxygenation with noninvasive ventilation before intubation in hypoxemic patients in intensive care unit. A multicenter randomized controlled trial.
Protocol code: DR240020
Sponsor: Centre Hospitalier Regional Universitaire De Tours (Hospital/Clinic/Other health care facility). Phase: Therapeutic confirmatory (Phase III). Countries: France (ongoing, recruiting).
Therapeutic area(s): Diseases [C] - Respiratory Tract Diseases [C08]
Gender: Female, Male. Age: 18-64 years, 65+ years. Enrolment: 500.
Status: Ongoing, recruiting. Start date (EU): 2026-03-18. Decision date: 2025-08-14. Results received: No. Last updated: 2026-07-23.

Condition(s): Hypoxemic acute respiratory failure
Product: OXYGENE MEDICINAL LIQUIDE AIR LIQUIDE SANTE FRANCE, gaz pour inhalation, pour évaporateur fixe

Primary endpoint: The incidence of severe hypoxemia defined as the occurrence of at least one episode of oxygen saturation measured by pulse oximetry (SpO2) < 80% (from the start of laryngoscopy to 5 minutes after successful intubation)
Endpoint(s): The incidence of prolonged severe hypoxemia defined by an SpO2 < 80% for more than 24 seconds (from the start of laryngoscopy to 5 minutes after successful intubation), The highest and lowest SpO2 values during the procedure (from the start of laryngoscopy to 5 minutes after successful intubation), The occurrence of each immediate severe complications (from the start of laryngoscopy to 5 minutes after successful intubation) including cardiovascular instability (systolic arterial blood pressure <65 mmHg at least once, new or increase need of vasopressors or fluid bolus >15 mL/kg), cardiac arrest, new onset cardiac arrhythmia (atrial fibrillation, ventricular tachycardia, bradycardia <30beats per minute)., The occurrence of each other adverse events: difficult intubation (defined as a procedure requiring more than 2 laryngoscopy attempts before success), operator-reported aspiration between induction and intubation, dental injury, esophageal intubation, pneumothorax visualized on the follow-up chest X-ray as part of the patient's routine care., The duration of laryngoscopy and the number of laryngoscopies will be compared in both group (from the 1st attempt to the successful intubation), Vital status at day 28

Source: https://euclinicaltrials.eu/ctis-public/view/2024-514949-11-00